EU clinical trial 2025-521508-23-00: A PHASE 1, OPENLABEL, SINGLECENTER STUDY TO EVALUATE DRUGDRUG INTERACTIONS WITH GEMFIBROZIL, ITRACONAZOLE, AND CARBAMAZEPINE AND THE FOOD-EFFECT ON ORAL LERIGLITAZONE IN MALE HEALTHY SUBJECTS
Protocol code: MT-1-02
Sponsor: Minoryx Therapeutics S.L. (Pharmaceutical company). Phase: Human Pharmacology (Phase I)- Other. Countries: Poland (ended).
Therapeutic area(s): Diseases [C] - Nervous System Diseases [C10]
Gender: Male. Age: 18-64 years. Enrolment: 73.
Status: Ended. Start date (EU): 2025-10-10. End date (EU): 2026-05-19. Decision date: 2025-08-04. Results received: No. Last updated: 2026-04-30.

Condition(s): Adrenoleukodystrophy
Product: Finlepsin 200 retard, 200 mg, tabletki o przedłużonym uwalnianiu, Orungal, 100 mg, kapsułki, Gemfibrozilo STADA 600 mg comprimidos recubiertos con película EFG, Neurotop retard 300, 300 mg, tabletki o przedłużonym uwalnianiu

Primary endpoint: To determine the DDI effect on the single-dose PK of oral leriglitazone as substrate when coadministered with gemfibrozil (Part A), itraconazole (Part B), or carbamazepine (Part C) as precipitants. Primary endpoint: Leriglitazone – Cmax, AUC(0-last), AUC(0-inf)., To determine the effect of food (highfat breakfast) on the single-dose PK of oral leriglitazone (Part D). Primary endpoint: Leriglitazone – Cmax, AUC(0-last), AUC(0-inf)
Endpoint(s): To determine the DDI effect on the single-dose PK of oral leriglitazone as substrate when coadministered with gemfibrozil (Part A), itraconazole (Part B), or carbamazepine (Part C) as precipitants. Secondary endpoints: a) Leriglitazone – tmax, λz, t1/2, CL/F, and Vz/F. b) M3 – Cmax, tmax, AUC(0-inf), λz, and t1/2. c) Metabolite/parent (MR) ratios [ie, MRCmax, MRAUC(0last), and MRAUC(0inf)]., To determine the effect of food (highfat breakfast) on the single-dose PK of oral leriglitazone (Part D). Secondary endpoint: a)Leriglitazone – tmax, λz, t1/2, CL/F, and Vz/F. b) M3 – Cmax, tmax, AUC(0-inf), λz, and t1/2. c) Metabolite/parent (MR) ratios [ie, MRCmax, MRAUC(0last), and MRAUC(0inf)]., Reported AEs, and changes in electrocardiograms (PR, QRS, QT, and QTcF), vital signs, and clinical safety laboratory tests., Parts A, B, and C: To explore the potential impact of CYP2C8 and CYP3A4 gene polymorphisms on the PK of leriglitazone. Endpoint: Serum gene expression levels of CYP2C8 and CYP3A4 polymorphism versus PK., Part B: To explore the potential impact of CYP3A5 gene polymorphism on the PK of leriglitazone when given concomitantly with CYP3A4 inhibitors (eg, itraconazole). Endpoint: Serum gene expression levels of CYP3A5 polymorphism versus PK.

Source: https://euclinicaltrials.eu/ctis-public/view/2025-521508-23-00